EU clinical trial 2023-506387-14-00: A Phase 1/2 Randomized, Umbrella Study to Evaluate the Efficacy and Safety of MK-2870 Plus Enfortumab Vedotin (EV) With and Without Pembrolizumab, as Treatment for Participants With Advanced Urothelial Carcinoma (KEYMAKER-U04): Substudy 04C
Protocol code: MK-3475-04C
Sponsor: Merck Sharp & Dohme LLC (Pharmaceutical company). Phase: Phase I and Phase II (Integrated)- First administration to humans. Countries: France (ended), Spain (ongoing, recruitment ended), Denmark (ended), Netherlands (ended), Italy (ended).
Therapeutic area(s): Diseases [C] - Neoplasms [C04]
Gender: Female, Male. Age: 18-64 years, 65+ years. Enrolment: 29.
Start date (EU): 2024-09-24. Decision date: 2024-09-03. Results received: No. Last updated: 2026-04-27.
Decision dates by country: FR: 2024-09-06, DK: 2024-09-05, ES: 2024-09-04, IT: 2024-09-09, NL: 2024-09-09

Condition(s): Advanced Urothelial Carcinoma
Product: DEXAMETHASONE, ENFORTUMAB VEDOTIN, PARACETAMOL, MK-2870, KEYTRUDA 25 mg/mL concentrate for solution for infusion

Primary endpoint: Part 1: Percentage of Participants with Dose-limiting toxicities (DLT), Part 1: Percentage of Participants Who Experienced At Least One Adverse Event (AE), Part 1: Percentage of Participants Who Discontinued Study Treatment Due to an AE, Not applicable: Part 2: Percentage of Participants with DLT, Not applicable: Part 2: Percentage of Participants Who Experienced At Least One AE, Not applicable: Part 2: Percentage of Participants Who Discontinued Study Treatment Due to an AE, Not applicable: Part 2: Objective Response Rate (ORR)
Endpoint(s): Part 1: ORR, Not applicable: Part 2: Duration of Response (DOR), Part 1: Maximum Serum Concentration (Cmax) of Sacituzumab Tirumotecan-Antibody-Drug Conjugate (ADC), Part 1: Serum Trough Concentration (Ctrough) of Sacituzumab Tirumotecan-ADC, Part 1: Cmax of Free Payload for Sacituzumab Tirumotecan, Part 1: Ctrough of Free Payload for Sacituzumab Tirumotecan, Part 1: Cmax of Enfortumab Vedotin-ADC, Part 1: Ctrough of Enfortumab Vedotin-ADC, Part 1: Cmax of Free Payload for Enfortumab Vedotin, Part 1: Ctrough of Free Payload for Enfortumab Vedotin, Part 1: Incidence of Antidrug Antibodies (ADA) to Sacituzumab Tirumotecan, Part 1: Incidence of ADA to Enfortumab Vedotin, Not applicable: Part 2: Cmax of Sacituzumab Tirumotecan-ADC, Not applicable: Part 2: Ctrough of Sacituzumab Tirumotecan-ADC, Not applicable: Part 2: Cmax of Free Payload for Sacituzumab Tirumotecan, Not applicable: Part 2: Ctrough of Free Payload for Sacituzumab Tirumotecan, Not applicable: Part 2: Cmax of Enfortumab Vedotin-ADC, Not applicable: Part 2: Ctrough of Enfortumab Vedotin-ADC, Not applicable: Part 2: Cmax of Free Payload for Enfortumab Vedotin, Not applicable: Part 2: Ctrough of Free Payload for Enfortumab Vedotin, Not applicable: Part 2: Cmax of Pembrolizumab-ADC, Not applicable: Part 2: Ctrough of Pembrolizumab-ADC, Not applicable: Part 2: Cmax of Free Payload for Pembrolizumab, Not applicable: Part 2: Ctrough of Free Payload for Pembrolizumab, Not applicable: Part 2: Incidence of ADA to Sacituzumab Tirumotecan, Not applicable: Part 2: Incidence of ADA to Enfortumab Vedotin, Not applicable: Part 2: Incidence of ADA to Pembrolizumab

Source: https://euclinicaltrials.eu/ctis-public/view/2023-506387-14-00